EU clinical trial 2025-524005-32-00: A Phase 2, Randomized, Double-blind, Placebo-controlled Study to Investigate the Safety and Efficacy of ELV001 as Add-on Therapy in Patients with Active Rheumatoid Arthritis and Inadequate Response to Methotrexate and Tumor Necrosis Factor Inhibition (START SYNERGY)
Protocol code: ELV001-201
Sponsor: Elevara Medicines Limited (Pharmaceutical company). Phase: Therapeutic exploratory (Phase II). Countries: Czechia (authorised, recruitment pending), Bulgaria (authorised, recruitment pending), Hungary (authorised, recruitment pending), Netherlands (authorised, recruitment pending), Poland (authorised, recruitment pending), Spain (authorised, recruitment pending).
Therapeutic area(s): Diseases [C] - Immune System Diseases [C20]
Gender: Female, Male. Age: 18-64 years, 65+ years. Enrolment: 95.
Status: Authorised, recruitment pending. Decision date: 2026-05-19. Results received: No. Last updated: 2026-05-26.
Decision dates by country: BG: 2026-05-26, CZ: 2026-05-20, HU: 2026-05-19, ES: 2026-05-22, NL: 2026-05-26, PL: 2026-05-25

Condition(s): Rheumatoid arthritis
Product: ELV100 Placebo Tablets

Primary endpoint: Change in DAS28-CRP between Baseline and Week 12. The primary comparison will be between placebo and the highest dose group.
Endpoint(s): Incidence and severity of TEAEs, including SAEs., Incidence and severity of AEs of special interest (AESIs)., Incidence and severity of SUSARs., Clinically significant abnormalities and change from Baseline in 12-lead ECG (including QTcF)., Clinically significant abnormalities and change from Baseline in vital signs., Change from Baseline in laboratory parameters (hematology, biochemistry, coagulation, and urinalysis)., Percentage of participants reaching remission and low disease activity as defined by DAS28-CRP at Week 12 and at Week 24., Percentage of participants reaching ACR20/ACR50/ACR70 at Week 12 and at Week 24., Change from Baseline to Week 12 and to Week 24 in swollen joint count, tender joint count, physician’s global assessment of disease activity (VAS), serum CRP levels, SDAI and CDAI., Change from Baseline to Week 12 and to Week 24 of participant’s global assessment of disease activity (VAS), participant’s global assessment of arthritis pain (VAS), participant’s assessment of physical function (HAQ-DI), SF-36, and FACIT-Fatigue Questionnaire., Assess dose response relationship on Disease Activity Scores., Plasma drug and drug metabolite concentrations, will include but not be limited to: Cmax, Tmax, AUC0-last, AUC0-inf, t½, λz, CL/F, Vz/F, and CLR following single oral dosing.

Source: https://euclinicaltrials.eu/ctis-public/view/2025-524005-32-00